EU clinical trial 2024-520128-27-00: BEvacizumab plus Trifluridine/tipiracil in a bi-WEEkly administration to reduce grade 3-4 Neutropenia in patients with mCRC: A prospective, multicenter, comparative, randomized GERCOR G-124 BETWEEN phase II study
Sponsor: Association Gercor (Laboratory/Research/Testing facility). Phase: Therapeutic exploratory (Phase II). Countries: France (ongoing, recruiting).
Therapeutic area(s): Diseases [C] - Digestive System Diseases [C06]
Gender: Female, Male. Age: 18-64 years, 65+ years. Enrolment: 162.
Status: Ongoing, recruiting. Start date (EU): 2026-03-04. Decision date: 2025-10-20. Results received: No. Last updated: 2025-10-20.

Condition(s): colorectal adenocarcinoma
Product: BEVACIZUMAB, TRIFLURIDINE, COMBINATIONS

Primary endpoint: The occurrence of grade 3-4 neutropenia in patients undergoing treatment with the combination of bevacizumab and bi-weekly administration of trifluridine/tipiracil (experimental arm) compared to a conventional administration (control arm).
Endpoint(s): OS in both arms,, PFS in both arms,, BOR in both arms,, DCR in both arms,, OS, PFS, BOR, and DCR in subgroups of patients with at least one episode of grade 3-4 neutropenia or without grade 3-4 neutropenia in both arms,, Incidence and grade of AEs and SAEs in both arms,, Incidence of dose delay, dose reduction, and dose reduction not related to grade 3-4 neutropenia in both arms,, Treatment compliance (Percentage of patients with compliance to treatment) in both arms,, Time to ECOG PS deterioration.

Source: https://euclinicaltrials.eu/ctis-public/view/2024-520128-27-00